EU clinical trial 2023-503987-18-00: A Trial Investigating the pain-relieving properties of Lu AG06474 in Healthy Adult Participants
Protocol code: 20435A
Sponsor: H. Lundbeck A/S (Pharmaceutical company). Phase: Human Pharmacology (Phase I)- Other. Countries: Netherlands (ended).
Therapeutic area(s): Phenomena and Processes [G] - Musculoskeletal and Neural Physiological Phenomena [G11]
Gender: Female, Male. Age: 18-64 years. Enrolment: 24.
Status: Ended. Start date (EU): 2023-10-03. End date (EU): 2024-05-17. Decision date: 2023-09-13. Results received: No. Last updated: 2024-02-27.

Condition(s): Pain

Source: https://euclinicaltrials.eu/ctis-public/view/2023-503987-18-00